EU clinical trial 2024-511406-23-00: Efficacy and safety of Ropivacaine injection in the management of post-operative pain: A comparison of plane block versus wound infiltration for post-operative analgesia in lumbar arthrodesis surgery.
Protocol code: ROPIDOL
Sponsor: Institut De Recerca Biomedica De Lleida Fundacio Dr. Pifarre (Laboratory/Research/Testing facility). Phase: Therapeutic use (Phase IV). Countries: Spain (authorised, recruiting).
Therapeutic area(s): Analytical,Diagnostic,Therapeutic Techniques and Equipment [E]-Surgical Procedures, Operative [E04]; Analytical, Diagnostic and Therapeutic Techniques and Equipment [E] - Anesthesia and Analgesia [E03]
Gender: Female, Male. Age: 18-64 years, 65+ years. Enrolment: 111.
Status: Authorised, recruiting. Start date (EU): 2025-11-13. Decision date: 2024-12-10. Results received: No. Last updated: 2025-07-04.

Condition(s): lumbar arthrodesis
Product: Ropivacaine B. Braun 10 mg/ml injektionsvätska, lösning

Primary endpoint: Morphine demand during the 48 hours after surgery
Endpoint(s): Changes in the VAS scale just after surgery, at 8, 16, 24 and 48 hours after surgery, Changes in SFMPQ at 24 and 48 hours after surgery, Changes in QoR-15 scales at 24 and 48 hours after surgery, Duration of hospitalization after surgery, Number of adverse effects associated with the drug within the first 48 hours after surgery

Source: https://euclinicaltrials.eu/ctis-public/view/2024-511406-23-00